EU clinical trial 2022-502359-75-00: Open-label, Single-arm, Phase 3 Study to Evaluate Safety, Tolerability, and Pharmacokinetics of Fenfluramine (Hydrochloride) in Infants 1 Year to less Than 2 Years of Age with Dravet Syndrome
Protocol code: EP0213
Sponsor: UCB Biosciences Inc. (Pharmaceutical company). Phase: Therapeutic confirmatory (Phase III). Countries: Germany (ended), Belgium (ongoing, recruitment ended), Italy (ended), Spain (ended).
Therapeutic area(s): Diseases [C] - Nervous System Diseases [C10]
Gender: Female, Male. Age: 0-17 years. Enrolment: 14.
Start date (EU): 2024-07-03. Decision date: 2023-09-19. Results received: No. Last updated: 2025-12-10.
Decision dates by country: ES: 2024-08-05, BE: 2023-09-21, IT: 2023-09-22, DE: 2023-09-19

Condition(s): Dravet syndrome
Product: Fintepla 2.2 mg/ml oral solution

Primary endpoint: Change from Baseline in QT interval corrected by Fridericia (QTcF) at Visit 13 (End of Treatment/Early Termination (EOT/ET)), Occurrence of a treatment-emergent (ie, post- Baseline through Visit 13 [EOT/ET]) result which meets the FDA case definition of drug associated valvulopathy, Occurrence of treatment-emergent (ie, post- Baseline through Visit 13 [EOT/ET]) clinically confirmed valvular heart disease (VHD), Change from Baseline in body weight (Z-score) at each visit, Change from Baseline in recumbent length (Z-score) at each visit, Occurrence of a clinically significant abnormality on the neurological examination at each visit
Endpoint(s): Percentage change from the Baseline Period (ie, Baseline) in monthly (28 days) countable motor seizure frequency (CMSF), during Weeks 9 through 20, Percentage change from Baseline in CMSF during Weeks 1 through 20, Percentage change from Baseline in CMSF during the Treatment Period (Week 1 through the EOT/ET Visit), Achievement of a Clinical Global Impression – Improvement (CGI-I) rating of “much improved” or “very much improved” as assessed by the Principal Investigator at Week 20, Achievement of a CGI-I rating of “much improved” or “very much improved” as assessed by the parent/caregiver at Week 20, Steady-state maximum plasma concentration (Cmax) of fenfluramine and norfenfluramine at Week 12, Steady-state minimum plasma concentration (Cmin) of fenfluramine and norfenfluramine at Week 12, Area under the plasma concentration time curve from time zero to 24 hours (AUC0-24) for steady-state fenfluramine and norfenfluramine at Week 12

Source: https://euclinicaltrials.eu/ctis-public/view/2022-502359-75-00